EU clinical trial 2024-518615-19-00: A Double-blind, Randomized, Psychoactive Placebo-controlled Study to Evaluate the Efficacy and Safety of Intranasal Esketamine 84 mg in Addition to Comprehensive Standard of Care for the Rapid Reduction of the Symptoms of Major Depressive Disorder in Adolescent Participants with Acute Suicidal Ideation or Behavior
Protocol code: 54135419SUI3003
Sponsor: Janssen Cilag International (Pharmaceutical company). Phase: Therapeutic confirmatory (Phase III). Countries: Italy (authorised, recruiting), Hungary (authorised, recruiting), Spain (authorised, recruiting), Romania (authorised, recruitment pending).
Therapeutic area(s): Psychiatry and Psychology [F] - Mental Disorders [F03]
Gender: Female, Male. Age: 0-17 years. Enrolment: 96.
Start date (EU): 2026-04-22. Decision date: 2025-11-19. Results received: No. Last updated: 2026-05-14.
Decision dates by country: IT: 2025-11-19, RO: 2025-11-24, HU: 2025-11-21, ES: 2025-11-21

Condition(s): Major Depressive Disorder
Product: Spravato 28 mg nasal spray, solution, Midazolam-ratiopharm® 2 mg/ml orale Lösung, Oral placebo, Intranasal Placebo

Primary endpoint: Change from baseline (Day 1, predose) at 24 hours post first dose in depressive symptoms, as measured by the CDRS-R total score

Source: https://euclinicaltrials.eu/ctis-public/view/2024-518615-19-00